EU clinical trial 2022-502781-24-01: A Phase 3 Randomized, Placebo-Controlled Clinical Study to Evaluate the Efficacy and Safety of MK-0616 in Reducing Major Adverse Cardiovascular Events in Participants at High Cardiovascular Risk
Protocol code: MK 0616-015
Sponsor: Merck Sharp & Dohme LLC (Pharmaceutical company). Phase: Therapeutic confirmatory (Phase III). Countries: France (ongoing, recruitment ended), Denmark (ongoing, recruitment ended), Hungary (ongoing, recruitment ended), Italy (ongoing, recruitment ended), Netherlands (ongoing, recruitment ended), Germany (ongoing, recruitment ended), Norway (ongoing, recruitment ended), Spain (ongoing, recruitment ended), Poland (ongoing, recruitment ended).
Therapeutic area(s): Diseases [C] - Cardiovascular Diseases [C14]
Gender: Female, Male. Age: 18-64 years, 65+ years. Enrolment: 3337.
Status: Ongoing, recruitment ended. Start date (EU): 2024-06-05. Decision date: 2024-06-03. Results received: No. Last updated: 2026-08-07.
Decision dates by country: PL: 2024-07-09, FR: 2024-06-04, HU: 2024-06-07, NL: 2024-06-10, DE: 2024-06-04, NO: 2024-06-05, ES: 2024-06-03, IT: 2024-06-03, DK: 2024-06-04

Condition(s): ASCVD - Atherosclerotic Cardiovascular Disease
Product: MK-0616, Placebo to MK-0616 - Tablet

Primary endpoint: Blinded Period: Time to First Occurrence of CHD Death-Based MACE-Plus
Endpoint(s): Blinded Period: Time to First Occurrence of 3-point MACE, Blinded Period: Time to First Occurrence of CV Death-Based MACE-Plus, Blinded Period: Time to First Occurrence of CHD Death or MI, Blinded Period: Time to Cardiovascular death, Blinded Period: Time to All-cause death, Blinded Period: Time to First Event of MI, Blinded Period: Time to First Event of Ischemic Stroke, Blinded Period: Time to First Event of Acute Limb Ischemia or Major Amputation, Blinded Period: Time to First Event of Urgent Arterial Revascularization, Blinded Period: Percent Change from Baseline in Low-Density Lipoprotein Cholesterol (LDL-C), Blinded Period: Percent Change from Baseline in Apolipoprotein B, Blinded Period: Percent Change from Baseline in Non-High-Density Lipoprotein Cholesterol (non-HDL-C) cholesterol, Blinded Period: Percent Change from Baseline in Lipoprotein (a), Blinded Period: Number of Participants with an Adverse Event (AE), Blinded Period: Number of Participants Discontinuing from Study Therapy due to AE, OLE: Time to First Occurrence of CV Death-Based MACE-Plus

Source: https://euclinicaltrials.eu/ctis-public/view/2022-502781-24-01